EU clinical trial 2022-502185-24-00: A randomised, controlled trial to investigate the effect of a four/six week intensified pharmacological treatment for schizophrenia, major depressive disorder and bipolar depression compared to treatment as usual in subjects who had a first-time treatment failure on their first-line treatment.
Protocol code: INTENSIFY
Sponsor: University Medical Center Utrecht (Hospital/Clinic/Other health care facility). Phase: Therapeutic confirmatory (Phase III). Countries: Germany (not authorised), Italy (not authorised), Austria (not authorised), Spain (not authorised).
Therapeutic area(s): Psychiatry and Psychology [F] - Mental Disorders [F03]
Gender: Female, Male. Age: 18-64 years, 65+ years. Enrolment: 945.
Status: Not authorised. Decision date: 2023-06-16. Results received: No. Last updated: 2023-06-19.
Decision dates by country: AT: 2023-06-19, DE: 2023-06-19, IT: 2023-06-16, ES: 2023-06-16

Condition(s): Schizophrenia, schizoaffective disorder, schizophreniform disorder, major depressive disorder or bipolar disorder type I and II (currently in a depressive episode)
Product: Spravato 28 mg nasal spray, solution, ESKETAMINE, BUPROPION, QUETIAPINE, VALPROIC ACID, VENLAFAXINE, LAMOTRIGINE, KETAMINE, SERTRALINE, DULOXETINE, CLOZAPINE, ESCITALOPRAM, LITHIUM

Primary endpoint: Change in symptom severity total score from baseline (visit 2) to four-weeks (MDD)/six-weeks (SZ/BD) (visit 4). For SZ, this is measured using the Positive And Negative Syndrome Scale. For MDD and BD, Montgomery Asberg Depression Rating Scale is applied.
Endpoint(s): The secondary endpoints are already described in the secondary objectives

Source: https://euclinicaltrials.eu/ctis-public/view/2022-502185-24-00